EU clinical trial 2023-506792-94-00: VulVaccin study: Adjuvant nonavalent HPV vaccination in women treated for vulvar HSIL, a Randomised Placebo Controlled Trial.
Sponsor: Erasmus Universitair Medisch Centrum Rotterdam (Erasmus MC) (Hospital/Clinic/Other health care facility). Phase: Phase III and phase IV (Integrated). Countries: Netherlands (ongoing, recruiting).
Therapeutic area(s): Diseases [C] - Female Urogenital Diseases and Pregnancy Complications [C13]; Diseases [C] - Virus Diseases [C02]
Gender: Female. Age: 18-64 years, 65+ years. Enrolment: 498.
Status: Ongoing, recruiting. Start date (EU): 2024-03-04. Decision date: 2024-01-24. Results received: No. Last updated: 2026-03-11.

Condition(s): Vulvar High-Grade Squamous Intraepithelial Lesion (vHSIL)
Product: Sodium Chloride 0.9%, Gardasil 9 suspension for injection. Human Papillomavirus 9-valent Vaccine (Recombinant, adsorbed)

Primary endpoint: Difference in number and percentage of patients with clinical recurrence rate of vulvar HSIL between HPV vaccination and placebo up to 24 months post-treatment.
Endpoint(s): Difference in number and percentage of patients with clinical recurrence rate of vulvar HSIL between HPV vaccination and placebo at 6 and 12 months., Difference in number and percentage of patients with clinical recurrence rate of vulvar HSIL between HPV vaccination and placebo at 6 and 12 months for primary vHSIL versus recurrent vHSIL., Difference in number and percentage of patients with clinical recurrence rate of vulvar HSIL between the different treatment modalities., Difference in number and percentage for additional treatment necessary after primary treatment., Description and percentage of different HPV types. Percentage clearance of primary HPV type for vaccination versus placebo., Number of HPV antibodies and percentage of increase or decrease after vaccination. Is there correlation between number or percentage of recurrence. Is that different in primary versus recurrent episode vHSIL., Incremental cost-effectiveness ratio (ICER), described the difference in costs and budget impact analysis., Description and change in numeric value and percentage in different score form questionnaires. Percentage increase of decrease quality of life, sexual impact and productivity impact., Difference number and percentage in HPV types cervical cytology and vHSIL before and after vaccination., Difference in number and percentage in recurrence rate of vulvar HSIL and vulvar cancer between HPV vaccination and placebo. Other HPV related disease known?

Source: https://euclinicaltrials.eu/ctis-public/view/2023-506792-94-00